EU clinical trial 2023-503701-11-00: Pilot study RCT anti-NGF Adalimumab versus placebo in fasciotomy Dupuytren contracture
Protocol code: S67402
Sponsor: UZ Leuven (Hospital/Clinic/Other health care facility). Phase: Therapeutic confirmatory (Phase III). Countries: Belgium (ended).
Therapeutic area(s): Diseases [C] - Skin and Connective Tissue Diseases [C17]
Gender: Female, Male. Age: 18-64 years, 65+ years. Enrolment: 30.
Status: Ended. Start date (EU): 2023-10-16. End date (EU): 2026-01-19. Decision date: 2023-07-05. Results received: Yes. Last updated: 2023-12-15.

Condition(s): Dupuytren Disease
Product: ADALIMUMAB, SALINE

Primary endpoint: Obtain a minimum increase of 10° correction of the finger extension lack in the treatment group versus the placebo.
Endpoint(s): Recurrence Rate, QuickDASH, Pain score: Visual Analogue Scale, Patient satisfaction: Visual Analogue Scale

Source: https://euclinicaltrials.eu/ctis-public/view/2023-503701-11-00